EU clinical trial 2024-516009-22-00: A Phase 3, Randomized, Double-Blind, Placebo-Controlled Study to Evaluate the Efficacy and Safety of Elritercept (KER-050) for the Treatment of Transfusion-Dependent Anemia in Adult Participants with Very Low-, Low-, or Intermediate-Risk Myelodysplastic Syndromes (MDS) (RENEW)
Protocol code: KER-050-D301
Sponsor: Takeda Development Center Americas Inc. (Pharmaceutical company). Phase: Therapeutic confirmatory (Phase III). Countries: Italy (ongoing, recruiting), Lithuania (ongoing, recruiting), Sweden (ongoing, recruiting), Spain (ongoing, recruiting), Germany (ongoing, recruiting), France (ongoing, recruiting), Bulgaria (ongoing, recruiting), Hungary (ongoing, recruiting), Ireland (ongoing, recruiting), Czechia (authorised, recruiting), Poland (ongoing, recruiting).
Therapeutic area(s): Diseases [C] - Hemic and Lymphatic Diseases [C15]
Gender: Female, Male. Age: 18-64 years, 65+ years. Enrolment: 80.
Start date (EU): 2025-04-30. Decision date: 2025-03-28. Results received: No. Last updated: 2026-08-07.
Decision dates by country: ES: 2025-03-31, LT: 2025-04-02, BG: 2025-04-03, FR: 2025-03-28, IE: 2025-04-07, HU: 2025-04-01, DE: 2025-03-31, PL: 2025-04-06, CZ: 2025-03-28, SE: 2025-03-28, IT: 2025-04-01

Condition(s): myelodysplastic neoplasms/syndromes (MDS)
Product: Placebo to match ker-050 solution for injection, elritercept

Primary endpoint: Proportion of participants achieving transfusion independence (TI) for ≥ 8 weeks from baseline through week 24
Endpoint(s): 1. Proportion of participants achieving TI for ≥ 24 weeks from baseline through week 48, 2. Proportion of participants with HTB achieving TI for ≥ 8 weeks from baseline through week 24, 3. Incidence of treatment-emergent adverse events (TEAEs) and serious adverse events (SAEs), 4. Change from baseline in clinical laboratory values, vital signs, and electrocardiograms (ECGs)

Source: https://euclinicaltrials.eu/ctis-public/view/2024-516009-22-00